EU clinical trial 2025-522423-95-00: Pharmacokinetics, pharmacodynamics, safety, and tolerability of an acetonic milk thistle extract, standardized to silymarin, in subjects with MASLD
Protocol code: SilMAKin
Sponsor: Bionorica SE (Pharmaceutical company). Phase: Human Pharmacology (Phase I)- Other. Countries: Germany (ongoing, recruiting).
Therapeutic area(s): Diseases [C] - Nutritional and Metabolic Diseases [C18]
Gender: Female, Male. Age: 18-64 years, 65+ years. Enrolment: 48.
Status: Ongoing, recruiting. Start date (EU): 2026-01-14. Decision date: 2025-11-17. Results received: No. Last updated: 2026-03-19.

Condition(s): chronic liver disease

Source: https://euclinicaltrials.eu/ctis-public/view/2025-522423-95-00